EU clinical trial 2026-525834-45-00: LAFOV-Lung PET
Sponsor: Medical University Of Vienna (Educational Institution). Phase: Human Pharmacology (Phase I)- First administration to humans. Countries: Austria (authorised, recruitment pending).
Therapeutic area(s): Analytical, Diagnostic and Therapeutic Techniques and Equipment [E] - Diagnosis [E01]
Gender: Female, Male. Age: 18-64 years. Enrolment: 41.
Status: Authorised, recruitment pending. Decision date: 2026-06-29. Results received: No. Last updated: 2026-06-29.

Condition(s): Investigation in healthy volunteers

Source: https://euclinicaltrials.eu/ctis-public/view/2026-525834-45-00